EU clinical trial 2023-507195-43-00: A clinical trial to learn how an investigational drug (MP-101) affects on the laboratory signs of the disease when given to Amyotrophic Lateral Sclerosis (ALS) and Alzheimer’s Disease (AD) patients
Protocol code: MP-101-02
Sponsor: Mitochon Pharmaceuticals Inc. (Pharmaceutical company). Phase: Human Pharmacology (Phase I)- Other. Countries: Hungary (ongoing, recruiting).
Therapeutic area(s): Diseases [C] - Nervous System Diseases [C10]
Gender: Female, Male. Age: 18-64 years, 65+ years. Enrolment: 40.
Status: Ongoing, recruiting. Start date (EU): 2024-07-01. Decision date: 2023-11-28. Results received: No. Last updated: 2025-08-01.

Condition(s): Amyotrophic Lateral Sclerosis (ALS), Alzheimer’s Disease (AD)

Source: https://euclinicaltrials.eu/ctis-public/view/2023-507195-43-00